EU clinical trial 2023-504803-10-00: A Phase 2, Single-Blind, Placebo-Controlled, Fixed-Sequence Design Trial to Evaluate the Photoparoxysmal Electroencephalogram Response, Safety, Tolerability, and Pharmacokinetics of PRAX-628 in Participants with Epilepsy and a Photoparoxysmal Electroencephalogram Response to Intermittent Photic Stimulation
Sponsor: Praxis Precision Medicines Inc. (Pharmaceutical company). Phase: Therapeutic exploratory (Phase II). Countries: Netherlands (ended).
Therapeutic area(s): Diseases [C] - Nervous System Diseases [C10]
Gender: Female, Male. Age: 18-64 years, 65+ years. Enrolment: 12.
Status: Ended. Start date (EU): 2023-06-15. End date (EU): 2024-03-14. Decision date: 2023-06-09. Results received: Yes. Last updated: 2024-03-15.

Condition(s): IPS induced photoparoxysmal electroencephalogram response (IPS-induced PPR) in participants with epilepsy and IPS-induced PPR
Product: PRAX-628, PRAX-628, PRAX-628, Placebo for PRAX-628

Primary endpoint: Reduction or abolishment of the IPS-induced PPR
Endpoint(s): Plasma concentrations of PRAX-628, Maximum observed concentration (Cmax), Time to maximum observed concentration (tmax), Area under the concentration-time curve from time zero to 24 hours (AUC24), Incidence and severity of adverse events (AEs), Changes in vital sign measurements, Changes in clinical laboratory results, Changes in electrocardiogram (ECG) parameters

Source: https://euclinicaltrials.eu/ctis-public/view/2023-504803-10-00